EU clinical trial 2024-516019-26-00: RR001 in Combination with Chemotherapy for Patients with Locally Advanced Pancreatic Adenocarcinoma: Open-label, Non-randomized Dose Escalation Phase I/IIa Study
Protocol code: SNIPER
Sponsor: Eir Biotherapies S.r.l. (Laboratory/Research/Testing facility). Phase: Phase I and Phase II (Integrated)- First administration to humans. Countries: Italy (ongoing, recruiting).
Therapeutic area(s): Diseases [C] - Neoplasms [C04]
Gender: Female, Male. Age: 18-64 years, 65+ years. Enrolment: 18.
Status: Ongoing, recruiting. Start date (EU): 2025-06-25. Decision date: 2024-12-02. Results received: No. Last updated: 2026-02-25.

Condition(s): Ductal adenocarcinoma of pancreas, Locally advanced, non-resectable pancreatic adenocarcinoma
Product: Gemsol 40 mg/ml concentrato per soluzione per infusione, Abraxane 5 mg/ml powder for dispersion for infusion., Abraxane 5 mg/ml powder for dispersion for infusion., RR001

Primary endpoint: To investigate the safety of intratumoral injections of the gene therapy product RR001 administered by US guided injection in combination with standard of care therapy based on GEM/Nab-PTX, To establish the MTD and RP2D of intratumoral injections of RR001 after three dose levels delivery in combination with standard of care therapy
Endpoint(s): To investigate the feasibility of intratumoral injections of the gene therapy product RR001 administered by US guided injection in combination with standard of care therapy based on GEM/Nab-PTX, Antitumor activity: Target tumor response will be assessed by objective radiologic assessment using RECIST 1.1 criteria, Response rate: the overall response rates (ORR) for objective response (complete, partial responses, stable disease, progressive disease) will be assessed by objective radiographic assessment using RECIST 1.1 criteria, Percentage of patients successfully undergoing to surgery and percentage of pathological resection (R0 vs. R1 vs. R2), Time to disease progression (TTP), Overall survival (OS), Tumor markers in serum (CEA, CA19.9 if present at the diagnosis), Quality of life by scoring of quality of life according to the EORTC QLQ-C30 and QLQ-PAN26, Progression free survival (PFS)

Source: https://euclinicaltrials.eu/ctis-public/view/2024-516019-26-00